EU clinical trial 2023-509923-42-00: Chemotherapy-free trastuzumab and pertuzumab in HER2-positive breast cancer: FDG-PET response-adapted strategy The PHERGain study.
Protocol code: MedOPP096 - MO39229
Sponsor: Medica Scientia Innovation Research S.L. (Pharmaceutical company). Phase: Therapeutic exploratory (Phase II). Countries: Germany (ongoing, recruitment ended), France (ongoing, recruitment ended), Spain (ongoing, recruitment ended), Italy (ongoing, recruitment ended), Portugal (ongoing, recruitment ended).
Therapeutic area(s): Diseases [C] - Neoplasms [C04]
Gender: Female, Male. Age: 18-64 years, 65+ years. Enrolment: 345.
Status: Ongoing, recruitment ended. Start date (EU): 2017-07-06. Decision date: 2024-07-16. Results received: No. Last updated: 2026-02-25.
Decision dates by country: FR: 2024-07-24, PT: 2024-07-17, IT: 2024-07-29, ES: 2024-07-16, DE: 2024-07-19

Condition(s): HER2- positive breast cancer
Product: Herceptin 600 mg solution for injection in vial, Perjeta 420 mg concentrate for solution for infusion, Docetaxel Accord 160 mg/8 ml concentrate for solution for infusion, Tamoxifeno Teva 20 mg comprimidos EFG, Carboplatino Teva 10 mg/ml Concentrado para solución para perfusión, Letrozol Kern Pharma 2,5 mg comprimidos recubiertos con película EFG

Primary endpoint: The first co-primary endpoint is to evaluate the rate of pCR as defined by the absence of invasive disease in the breast and axilla (ypT0/isN0) at the time of surgery achieved with the combination of trastuzumab and pertuzumab (± endocrine therapy) as exclusive neoadjuvant treatment in PET responders patients (cohort B/PET responders) [PET/CT positive predictive value (PPV) for a pCR among patients who are PET responders]., The second co-primary endpoint is to evaluate 3-year iDFS rate defined as time from the first date of no disease (i.e., date of surgery) to invasive recurrence, new invasive disease, or death by any cause. Recurrence will be defined in accordance with the standardized efficacy endpoints (STEEP) criteria. The primary analysis will be to estimate 3-year iDFS rate in cohort B.
Endpoint(s): 3, 5, and 7-year iBCFS defined as time from the first date of no disease (i.e., date of surgery) to invasive breast cancer recurrence, or death by any cause. Recurrence Will be defined in accordance with the standardized efficacy endpoints (STEEP) criteria., pCR rates in the breast and axilla (ypT0/isN0) (cohort A; cohort B; cohorts A/B by PET responder status)., pCR rates in the breast (ypT0/is) (cohort A; cohort B; cohorts A/B by PET responder status)., RCB score (cohort A; cohort B; cohorts A/B by PET responder status)., pCR rates in the breast and axilla (ypT0/isN0) (cohort A; cohort B; cohorts A/B by PET responder status; HR status, HER2 status and tumor stage)., Rate of breast conserving surgery (cohort A; cohort B; cohorts A/B by PET responder status)., 18F-FDG PET/CT response rate (according to the adapted EORTC criteria) (cohort A; cohort B)., Optimal 18F-FDG PET/CT cut-off for pCR (cohort A; cohort B)., Other 18F-FDG PET quantification parameters beside SUVmax for pCR (cohort A; cohort B)., MRI response rate (according to the RECIST criteria version 1.1) (cohort A; cohort B; cohorts A/B by PET responder status)., Health-related quality of life (EORTC QLQ-C30 and QLQBR23 questionnaires) (cohort A; cohort B; cohort C; cohorts A/B by PET responder status)., 3, 5, and 7-year iDFS (cohort A; cohort B [with the exception of 3-year iDFS]; cohorts A/B by PET responder status, pCR status, HR status, HER2 status, and in patients who did not receive chemotherapy (group B/18FFDG- PET-responders who achieved a pCR))., 3, 5, and 7-year iBCR (cohort A; cohort B; cohorts A/B by PET responder status, pCR status, HR status, HER2 status, and in patients who did not receive chemotherapy (group B/18F-FDG-PET-responders who achieved a pCR))., 3, 5, and 7-year DDFS (cohort A; cohort B; cohorts A/B by PET responder status, pCR status, HR status, HER2 status, and in patients who did not receive chemotherapy (group B/18F-FDG-PET-responders who achieved a pCR))., 3, 5, and 7-year DFS (cohort A; cohort B; cohorts A/B by PET responder status, pCR status, HR status, HER2 status, and in patients who did not receive chemotherapy (group B/18F-FDG-PET-responders who achieved a pCR))., 3, 5, and 7-year adapted iDFS, DDFS, and DFS (patients with subclinical M1 at baseline by 18F-FDG PET/CT – cohort C)., 3, 5, and 7-year EFS (cohort A; cohort B; cohorts A/B by PET responder status, pCR status, HR status, HER2 status, and in patients who did not receive chemotherapy (group B/18F-FDG-PET-responders who achieved a pCR)., 3, 5, and 7-year OS (cohort A; cohort B; cohorts A/B by PET responder status, pCR status, HR status, HER2 status, and in patients who did not receive chemotherapy (group B/18F-FDG-PET-responders who achieved a pCR))., PFS (patients with subclinical M1 at baseline by 18F-FDG PET/CT – cohort C)., Adverse events, grade 3-4 adverse events, related adverse events, serious adverse events, related serious adverse events, and adverse events leading to discontinuation (cohort A; cohort B; cohorts A/B by PET responder status, pCR status, HR status, HER2 status, and in patients who did not receive chemotherapy (group B/18F-FDG-PET-responders who achieved a pCR)).

Source: https://euclinicaltrials.eu/ctis-public/view/2023-509923-42-00